EU clinical trial 2023-506717-21-00: Study protocol title: A Phase I/II, open-label, multi-center trial of [177Lu]Lu-NeoB in combination with capecitabine in adult patients with gastrin releasing peptide receptor positive, estrogen receptor-positive, human epidermal growth receptor-2 negative metastatic breast cancer after progression on previous endocrine therapy in combination with a CDK4/6 inhibitor
Protocol code: CAAA603D12101
Sponsor: Novartis Pharma AG (Pharmaceutical company). Phase: Phase I and Phase II (Integrated)- Other. Countries: Germany (ongoing, recruitment ended), Spain (ongoing, recruitment ended), France (ended), Netherlands (ended), Portugal (ended), Italy (ended).
Therapeutic area(s): Diseases [C] - Neoplasms [C04]
Gender: Female, Male. Age: 18-64 years, 65+ years. Enrolment: 40.
Start date (EU): 2024-10-02. Decision date: 2024-04-23. Results received: No. Last updated: 2026-04-15.
Decision dates by country: IT: 2024-04-23, DE: 2024-04-23, ES: 2024-04-23, FR: 2024-04-29, PT: 2024-04-26, NL: 2024-04-23

Condition(s): Breast Cancer
Product: CAPECITABINE, CAPECITABINE, TRIPTORELIN, [177Lu]-NeoB solution for infusion, LEUPRORELIN, AAA503, GOSERELIN

Primary endpoint: Phase I: Incidence and severity of AEs including dose limiting toxicities (DLTs), serious Adverse Events (SAEs), changes in laboratory parameters, vital signs and ECGs Tolerability: Dose interruptions, discontinuations, and reductions Phase II: ORR, CBR, TTR, DOR, PFS as per RECIST v1.1 by local investigator assessment Overall Survival (OS)
Endpoint(s): Phase I and II: ● Time activity curves (TACs) and absorbed radiation doses of [177Lu]Lu-NeoB in organs and tumor lesions ● Concentration of [177Lu]Lu-NeoB in blood over time and derived PK parameters, Phase I and II: ● Incidence and severity of adverse events following [68Ga]Ga-NeoB administration at screening, Phase I and II: ● Positive Percent Agreement (PPA) and Positive Predictive Agreement (PPrA) using conventional imaging as reference by central assessment, at screening, Phase I only: ● Visual assessment of image quality by central assessment, Phase I only: ● ORR, CBR, TTR, DOR, PFS as per RECIST v1.1 by local investigator assessment ● OS, Phase II only: ● Incidence and severity of AEs, SAEs, changes in laboratory parameters, vital signs and ECGs Dose interruptions, discontinuations, and reductions

Source: https://euclinicaltrials.eu/ctis-public/view/2023-506717-21-00